EU clinical trial 2024-518239-12-00: The effect of sacubitril/valsartan versus ramipril on left ventricular function and remodeling in patients with ischemic heart failure with mid-range ejection fraction.
Protocol code: DW.0701.005.2020P
Sponsor: Krakowski Szpital Specjalistyczny Im. Sw. Jana Pawla II (Hospital/Clinic/Other health care facility). Phase: Therapeutic confirmatory (Phase III). Countries: Poland (ongoing, recruiting).
Therapeutic area(s): Diseases [C] - Cardiovascular Diseases [C14]
Gender: Female, Male. Age: 18-64 years, 65+ years. Enrolment: 666.
Status: Ongoing, recruiting. Start date (EU): 2023-01-26. Decision date: 2024-12-16. Results received: No. Last updated: 2026-07-06.

Condition(s): heart failure with moderately reduced ejection fraction (HFmrEF)
Product: Placebo to RAMIPRIL PL3 PL4, RAMIPRIL, VALSARTAN AND SACUBITRIL, Placebo to VALSARTAN AND SACUBITRIL PL1 PL2

Primary endpoint: Change in left ventricular end-systolic volume after 12 months of treatment as measured by MRI.
Endpoint(s): Change in left ventricular end-diastolic volume measured by MRI in patients with ischemic HFmrEF after 12 months of treatment., Change in indexed left ventricular end-systolic and end-diastolic volumes measured by MRI in patients with ischemic HFmrEF after 12 months of treatment., Change in left ventricular ejection fraction measured by MRI in patients with ischemic HFmrEF after 12 months of treatment., Death from cardiovascular causes or first hospitalization due to HF in patients with ischemic HFmrEF over a 12 month treatment period., Death from cardiovascular causes or first or subsequent hospitalization due to HF in patients with ischemic HFmrEF over a 12 month treatment period., Death from cardiovascular causes in patients with ischemic HFmrEF over a 12 month treatment period., First hospitalization for HF in patients with ischemic HFmrEF over a 12 month treatment period., First or subsequent hospitalization for HF in patients with ischemic HFmrEF over a 12 month treatment period., Number of days until death from cardiovascular causes or first hospitalization for HF in patients with ischemic HFmrEF over a 12 month treatment period., All-cause death in patients with ischemic HFmrEF over a 12 month treatment period.

Source: https://euclinicaltrials.eu/ctis-public/view/2024-518239-12-00